EU clinical trial 2023-505441-69-00: INTEGRATE IIb A Randomised Phase III Open Label Study of regorafenib + nivolumab vs standard chemotherapy in Refractory Advanced Gastro-Oesophageal Cancer (AGOC)
Protocol code: AG0315OG/CTC0140
Sponsor: Institut fuer Klinische Krebsforschung IKF GmbH (Pharmaceutical company). Phase: Therapeutic confirmatory (Phase III). Countries: Austria (ended), Germany (ended), Italy (ended), Spain (ended).
Therapeutic area(s): Diseases [C] - Neoplasms [C04]
Gender: Female, Male. Age: 18-64 years, 65+ years. Enrolment: 125.
Status: Ended. Start date (EU): 2022-05-17. End date (EU): 2025-09-25. Decision date: 2023-09-04. Results received: No. Last updated: 2025-10-10.
Decision dates by country: AT: 2023-09-12, DE: 2023-09-04, ES: 2024-01-08, IT: 2024-01-12

Condition(s): refractory, advanced gastro-oesophageal cancer
Product: OPDIVO 10 mg/mL concentrate for solution for infusion., BAY 734506

Primary endpoint: Overall survival (OS) (death from any cause) in the overall study population
Endpoint(s): Overall survival (death from any cause) in the Asian sub-population, Progression free survival (PFS) (disease progression or death), Objective tumour response rate (OTRR) (partial or complete response (PR or CR)) according to Response Evaluation Criteria in Solid Tumours (RECIST) version 1.1, and immune-related iRECIST, Quality of life (QoL) (scores from participant-completed questionnaires), Safety (rates of adverse events), Translational Research: prognostic and predictive biomarkers (tissue and circulating) for study endpoints (relating to survival, response and safety), Translational Research: regorafenib PK in patient populations from different geographical regions (PK levels)

Source: https://euclinicaltrials.eu/ctis-public/view/2023-505441-69-00